EU clinical trial 2024-514057-30-00: Prospective feasibility pilot study evaluating the value of [68Ga]Ga-PENTIXAFOR PET-CT in patients with locally advanced or metastatic Small Cell Lung Cancer (SCLC) at diagnosis and disease progression (PASSIFLORE)
Protocol code: ICO-2023-16
Sponsor: Institut De Cancerologie De L Ouest (Hospital/Clinic/Other health care facility). Phase: Human Pharmacology (Phase I)- Other. Countries: France (authorised, recruitment pending).
Therapeutic area(s): Diseases [C] - Neoplasms [C04]
Gender: Female, Male. Age: 18-64 years, 65+ years. Enrolment: 15.
Status: Authorised, recruitment pending. Decision date: 2025-05-06. Results received: No. Last updated: 2026-03-12.

Condition(s): cell lung carcinoma

Source: https://euclinicaltrials.eu/ctis-public/view/2024-514057-30-00